EU clinical trial 2023-508603-21-00: A Master Protocol for a Phase 2 Randomized, Double-blind, Placebo-controlled Study of REGN9933 and REGN7508, Monoclonal Antibodies against Factor XI for Prevention of Venous Thromboembolism in Patients with a Peripherally Inserted Central Catheter (ROXI-CATH).
Protocol code: R9933-DVT-2308
Sponsor: Regeneron Pharmaceuticals Inc. (Pharmaceutical company). Phase: Therapeutic exploratory (Phase II). Countries: Spain (ended), Romania (ended), Bulgaria (ended).
Therapeutic area(s): Diseases [C] - Hemic and Lymphatic Diseases [C15]; Diseases [C] - Cardiovascular Diseases [C14]
Gender: Female, Male. Age: 18-64 years, 65+ years. Enrolment: 93.
Status: Ended. Start date (EU): 2024-09-20. End date (EU): 2026-03-05. End date: 2026-03-27. Decision date: 2024-08-12. Results received: No. Last updated: 2026-03-02.
Decision dates by country: ES: 2024-08-12, RO: 2024-08-14, BG: 2024-08-16

Condition(s): Venous Thromboembolism
Product: Placebo matching REGN9933, REGN7508, REGN9933, Placebo matching REGN7508

Primary endpoint: Incidence of confirmed VTE per central reading center (CRC) review, Incidence and severity of treatment-emergent adverse events (TEAE)
Endpoint(s): Incidence of confirmed PICC-associated venous thrombosis per CRC review, Incidence of major bleeding and clinically relevant non-major (CRNM) bleeding, Concentrations of REGN9933, Concentrations of REGN7508, Change in activated partial thromboplastin time (aPTT) and in prothrombin time (PT), Incidence and magnitude of anti-drug antibodies (ADA) to REGN9933 over time, Incidence and magnitude of ADA to REGN7508 over time

Source: https://euclinicaltrials.eu/ctis-public/view/2023-508603-21-00